EU clinical trial 2023-507241-28-00: Assessment of narrowing of blood vessels after single application of two clascoterone formulations (cream and solution) onto the skin in comparison to three marketed topical corticosteroids
Protocol code: CB-03-01/39
Sponsor: Cassiopea S.p.A. (Pharmaceutical company). Phase: Human Pharmacology (Phase I)- Other. Countries: Germany (ended).
Therapeutic area(s): Phenomena and Processes [G] - Physiological processes [G07]
Gender: Female, Male. Age: 18-64 years. Enrolment: 33.
Status: Ended. Start date (EU): 2024-02-26. End date (EU): 2024-04-10. Decision date: 2024-01-29. Results received: No. Last updated: 2024-01-29.

Condition(s): Test of vasocontriction properties for classification of topical steroid potency

Source: https://euclinicaltrials.eu/ctis-public/view/2023-507241-28-00